EU clinical trial 2024-515986-33-00: Dose escalating study to evaluate pharmacokinetics, efficacy and safety of apotransferrin in atransferrinemia patients
Protocol code: MD2009.04
Sponsor: Prothya Biosolutions Netherlands B.V. (Pharmaceutical company). Phase: Therapeutic exploratory (Phase II). Countries: Italy (ongoing, recruitment ended), Spain (ongoing, recruiting), Germany (ongoing, recruitment ended).
Therapeutic area(s): Diseases [C] - Congenital, Hereditary, and Neonatal Diseases and Abnormalities [C16]
Gender: Female, Male. Age: 0-17 years, 18-64 years. Enrolment: 5.
Start date (EU): 2010-11-12. Decision date: 2024-08-02. Results received: No. Last updated: 2026-04-14.
Decision dates by country: DE: 2024-08-05, ES: 2024-08-02, IT: 2024-08-26

Condition(s): Congenital atransferrinaemia/ hypotransferrinaemia
Product: Human Apotransferrin (50g/l)

Primary endpoint: Increase of hemoglobin (to normal range), Pharmacokinetics of transferrin, Decrease of serum ferritin (to normal range)
Endpoint(s): Increase of hematocrit (to normal range), Increase of erythrocytes (to normal range), Decrease of iron overload (liver, heart), Transferrin levels, transferrin saturation, and serum iron in relation to efficacy, Undetectable NTBI/LPI levels

Source: https://euclinicaltrials.eu/ctis-public/view/2024-515986-33-00